EU clinical trial 2023-509137-39-00: A randomized, phase 3 trial with anti-PD-1 monoclonal antibody pembrolizumab (MK-3475) versus placebo for patients with early stage NSCLC after resection and completion of standard adjuvant therapy (PEARLS) KEYNOTE-091
Protocol code: MK-3475-091
Sponsor: Merck Sharp & Dohme LLC (Pharmaceutical company). Phase: Therapeutic confirmatory (Phase III). Countries: Spain (ended), Denmark (ended), Czechia (ended), Latvia (ended), Italy (ended), Poland (ended), Hungary (ended), Belgium (ended), Ireland (ended), Greece (ended), Germany (ended), Slovenia (ended), Estonia (ended), France (ended), Netherlands (ended), Portugal (ended), Austria (ended).
Therapeutic area(s): Diseases [C] - Neoplasms [C04]
Gender: Female, Male. Age: 18-64 years, 65+ years. Enrolment: 430.
Status: Ended. Start date (EU): 2015-11-06. End date (EU): 2026-03-12. End date: 2026-03-13. Decision date: 2024-07-02. Results received: No. Last updated: 2026-04-07.
Decision dates by country: AT: 2024-07-09, FR: 2024-07-04, ES: 2024-07-03, IE: 2024-07-02, SI: 2024-07-11, DE: 2024-07-10, BE: 2024-07-12, CZ: 2024-07-04, EE: 2024-07-03, GR: 2024-07-22, NL: 2024-07-02, PL: 2024-07-18, DK: 2024-07-04, IT: 2024-07-15, HU: 2024-07-02, PT: 2024-07-03, LV: 2024-07-05

Condition(s): Stage IB (T ≥ 4 cm), II and IIIA NSCLC
Product: KEYTRUDA 25 mg/mL concentrate for solution for infusion, Sodium chloride

Primary endpoint: ♦ DFS in the PD-L1 strong positive subgroup;, ♦ DFS in the overall population.
Endpoint(s): ♦ DFS in the PD-L1 positive population;, ♦ OS in the overall population;, ♦ OS in the PD-L1 strong positive subgroup;, ♦ OS in the PD-L1 positive population;, ♦ LCSS in the overall population;, ♦ Toxicity according to CTCAE version 4.03.

Source: https://euclinicaltrials.eu/ctis-public/view/2023-509137-39-00